EU clinical trial 2025-523819-11-00: A Phase 3 Randomized, Open Label, Multicenter Study to Evaluate the Safety and Efficacy of ABBV-706 versus Standard of Care in Subjects with Relapsed/Refractory Small Cell Lung Cancer (SCLC)
Protocol code: M23-384
Sponsor: AbbVie Deutschland GmbH & Co. KG (Pharmaceutical company). Phase: Therapeutic confirmatory (Phase III). Countries: Italy (authorised, recruitment pending), Greece (authorised, recruitment pending), Spain (authorised, recruitment pending), Belgium (authorised, recruitment pending), France (authorised, recruitment pending), Austria (authorised, recruitment pending), Germany (authorised, recruitment pending).
Therapeutic area(s): Diseases [C] - Neoplasms [C04]
Gender: Female, Male. Age: 18-64 years, 65+ years. Enrolment: 125.
Status: Authorised, recruitment pending. Decision date: 2026-07-27. Results received: No. Last updated: 2026-08-02.
Decision dates by country: AT: 2026-08-02, BE: 2026-07-27, FR: 2026-07-28, DE: 2026-07-31, GR: 2026-07-27, IT: 2026-07-28, ES: 2026-07-30

Condition(s): Small Cell Lung Cancer
Product: TOPOTECAN, TOPOTECAN, ABBV-706, TOPOTECAN

Primary endpoint: Objective Response (OR) as Measured by Overall Response Rate (ORR) Based on Blinded Independent Central Review (BICR), Overall Survival (OS)
Endpoint(s): Progression-free survival (PFS) based on BICR assessment per RECIST v1.1., Duration of response (DoR) based on BICR assessment per RECIST v1.1., Change from baseline at Week 12 in physical functioning as measured by the physicalfunctioning domain of the EORTC QLQ-C30., Change from baseline at Week 12 in Global Health Status (GHS)/Quality of life (QoL) as measured by the EORTC QLQ-C30 GHS/QoL scale

Source: https://euclinicaltrials.eu/ctis-public/view/2025-523819-11-00